EU clinical trial 2024-513519-28-00: Multicenter phase 3 trial comparing NeoADjuvant Ipilimumab + Nivolumab versus standard Adjuvant nivolumab in macroscopic stage III melanoma – NADINA
Protocol code: M23MAR
Sponsor: Het Nederlands Kanker Instituut-Antoni van Leeuwenhoek Ziekenhuis Stichting (Hospital/Clinic/Other health care facility). Phase: Therapeutic confirmatory (Phase III). Countries: Netherlands (ongoing, recruitment ended), Italy (ongoing, recruitment ended), France (ongoing, recruitment ended), Poland (ongoing, recruitment ended).
Therapeutic area(s): Diseases [C] - Neoplasms [C04]
Gender: Female, Male. Age: 0-17 years, 18-64 years. Enrolment: 280.
Status: Ongoing, recruitment ended. Start date (EU): 2021-07-23. Decision date: 2024-06-19. Results received: No. Last updated: 2026-03-26.
Decision dates by country: FR: 2024-06-24, IT: 2024-06-25, PL: 2024-10-21, NL: 2024-06-19

Condition(s): Stage III melanoma
Product: OPDIVO 10 mg/mL concentrate for solution for infusion., YERVOY 5 mg/ml concentrate for solution for infusion

Primary endpoint: EFS, defined as time from randomization to melanoma progression (irresectable stage III or stage IV disease), melanoma recurrence, treatment-related death, or melanoma-related death, whichever occurs first.
Endpoint(s): OS, defined as time between date of randomization and date of death from any cause;, RFS, defined as time between date of surgery and date of melanoma recurrence, treatment-related death or melanoma-related death, whichever occurs first;, DMFS, defined as time between date of randomization and date of first distant metastasis, treatment-related death or melanoma-related death, whichever occurs first;, EFS including new primary melanoma, defined as time from randomization to a new primary melanoma (excluding melanoma in situ), melanoma progression (irresectable stage III or stage IV disease), melanoma recurrence, treatment-related death, or melanoma-related death, whichever occurs first;, Pathologic response rate (categorized into pCR, near-pCR, MPR, pPR, pNR, according to INMC criteria70, see 7.1.1) in the neoadjuvant arm;, Correlation of pathologic response in the neoadjuvant arm to RFS, DMFS, and OS;, Frequency and duration of all grade and grade 3-5 treatment-related adverse events according to CTCAE 5.0;, Surgical complication rates according to Clavien-Dindo surgical classification;, Quality of life as measured by EORTC QLQ C30, the Melanoma Subscale and Melanoma Surgery Subscale of FACT-M, the Cancer Worry Scale, HADS questionnaire, EQ-5D-5L, the immunotherapy-specific questionnaire, an assessment of work performance, sexual health, and Amsterdam Cognition Scan;, Performing health technology assessments comparing the neoadjuvant arm with the standard adjuvant arm.

Source: https://euclinicaltrials.eu/ctis-public/view/2024-513519-28-00